EU clinical trial 2024-518865-85-00: BBB-PET; Evaluation of [18F]MC225 to measure P-glycoprotein function in neurodegenerative disease
Sponsor: Universitair Medisch Centrum Groningen (Hospital/Clinic/Other health care facility). Phase: Therapeutic exploratory (Phase II). Countries: Netherlands (authorised, recruitment pending).
Therapeutic area(s): Analytical, Diagnostic and Therapeutic Techniques and Equipment [E] - Diagnosis [E01]; Diseases [C] - Nervous System Diseases [C10]
Gender: Female, Male. Age: 18-64 years, 65+ years. Enrolment: 30.
Status: Authorised, recruitment pending. Decision date: 2024-12-02. Results received: No. Last updated: 2026-01-19.

Condition(s): Alzheimers Disease, sporadic Cerebral Amyloid Angiopathy, Parkinson
Product: 5-(1-(2-[18F] fluoroethoxy))-[3-(6,7-dimethoxy-3,4-dihydro-1H-isoquinolin-2-yl)-propyl]-5,6,7,8-tetrahydronaphthalen

Primary endpoint: Regionale PET tracer uptake en influx waarden van [18F]MC225
Endpoint(s): CBF - cerebral blood flow values obtained with [15O]H2O PET MRI (vessel architecture) VAI measurements Arterial samples replaced with less invasive venous samples

Source: https://euclinicaltrials.eu/ctis-public/view/2024-518865-85-00